EU clinical trial 2025-522630-31-00: Evaluation of AG-181 in Subjects 18 to 69 Years of Age With Phenylketonuria
Protocol code: AG181-C-002
Sponsor: Agios Pharmaceuticals Inc. (Pharmaceutical company). Phase: Human Pharmacology (Phase I)- Other. Countries: Poland (ongoing, recruiting).
Therapeutic area(s): Diseases [C] - Nutritional and Metabolic Diseases [C18]
Gender: Female, Male. Age: 18-64 years, 65+ years. Enrolment: 10.
Status: Ongoing, recruiting. Start date (EU): 2026-06-02. Decision date: 2026-04-03. Results received: No. Last updated: 2026-06-18.

Condition(s): Phenylketonuria

Source: https://euclinicaltrials.eu/ctis-public/view/2025-522630-31-00